EU clinical trial 2024-510960-22-00: Phase I/II study to evaluate the efficacy and safety of PAZOPANIB in combination with TEMOZOLOMIDE as maintenance therapy in Glioblastoma patients undergoing surgery and subsequently treated with induction radiotherapy-TEMOZOLOMIDE
Sponsor: Centre Antoine Lacassagne (Hospital/Clinic/Other health care facility). Phase: Phase I and Phase II (Integrated)- Other. Countries: France (ongoing, recruitment ended).
Therapeutic area(s): Diseases [C] - Neoplasms [C04]
Gender: Female, Male. Age: 18-64 years, 65+ years. Enrolment: 56.
Status: Ongoing, recruitment ended. Start date (EU): 2015-06-25. Decision date: 2024-04-22. Results received: No. Last updated: 2025-10-20.

Condition(s): gliobastoma

Source: https://euclinicaltrials.eu/ctis-public/view/2024-510960-22-00